EU clinical trial 2023-504066-39-00: A Phase 1/Phase 2 Trial to Evaluate Safety, Immunogenicity and PSA Response of VTP-850 Prostate Cancer Immunotherapeutic in Men with Biochemical Recurrence after Definitive Local Therapy for Prostate Cancer
Protocol code: PCA001
Sponsor: Vaccitech PLC (Pharmaceutical company). Phase: Phase I and Phase II (Integrated)- First administration to humans. Countries: Spain (not authorised).
Therapeutic area(s): Diseases [C] - Neoplasms [C04]; Diseases [C] - Male Urogenital Diseases [C12]
Gender: Male. Age: 18-64 years, 65+ years. Enrolment: 22.
Status: Not authorised. Decision date: 2023-06-15. Results received: No. Last updated: 2023-06-15.

Condition(s): Prostate Cancer

Source: https://euclinicaltrials.eu/ctis-public/view/2023-504066-39-00